EU clinical trial 2024-513099-17-00: Clemastine fumarate as remyelinating treatment in internuclear ophthalmoparesis and multiple sclerosis (RESTORE)
Sponsor: Amsterdam UMC Stichting (Hospital/Clinic/Other health care facility). Phase: Therapeutic confirmatory (Phase III). Countries: Netherlands (ended).
Therapeutic area(s): Diseases [C] - Nervous System Diseases [C10]
Gender: Female, Male. Age: 18-64 years, 65+ years. Enrolment: 80.
Status: Ended. Start date (EU): 2022-08-30. End date (EU): 2025-08-15. Decision date: 2024-08-14. Results received: No. Last updated: 2025-01-30.

Condition(s): Internuclear ophthalmoparesis, Multiple sclerosis
Product: Capsules for oral use otherwise identical to IMP clemastine, Clemastine Milstein 1 mg, tabletten, Fampyra 10 mg prolonged-release tablets

Primary endpoint: The relative change in Versional Dysconjugacy Index (VDI) of Area under the Curve (AUC) from baseline will be compared between the treatment and control group at the end of treatment (6 months) and multiple follow-up periods (12, 24 and 36 months)

Source: https://euclinicaltrials.eu/ctis-public/view/2024-513099-17-00